EU clinical trial 2024-515552-21-00: A Phase I Clinical Study Evaluating the Safety of Peptide Receptor Radionuclide Therapy (PRRT) with 177Lu-DOTA0-Tyr3-Octreotate in Children with Refractory or Recurrent Neuroblastoma expressing somatostatin receptors
Protocol code: 15TETE04
Sponsor: Oncopole Claudius Regaud (Hospital/Clinic/Other health care facility). Phase: Human Pharmacology (Phase I)- Other. Countries: France (ended).
Therapeutic area(s): Diseases [C] - Neoplasms [C04]
Gender: Female, Male. Age: 0-17 years. Enrolment: 18.
Status: Ended. Start date (EU): 2023-04-17. End date (EU): 2026-04-17. Decision date: 2024-08-02. Results received: No. Last updated: 2025-10-08.

Condition(s): Recurrent or refractory neuroblastoma.
Product: Lutathera 370 MBq/mL solution for infusion, LysaKare 25 g/25 g solution for infusion

Primary endpoint: The primary endpoint is to define the Maximum Tolerated Dose (MTD) of 177Lu-DOTATATE. DLT period will start from the first injection of 177Lu- DOTATATE until 6 weeks after 1st injection.
Endpoint(s): Safety will be evaluated using NCI CTCAE V5.0 and clinical dosimetry of the blood and kidneys., Total Absorbed dose to the kidneys (considering both previous absorbed dose due to external beam irradiation and 177Lu-DOTATATE irradiation) will be defined., Efficacy: will be evaluated using the INRC (2017), RECIST v1.1 criteria and investigator judgment. Objective Response Rate (ORR) will be defined as the number of patients with best objective response (i.e. complete response or partial response) divided by the total number of evaluable patients. Progression Free Survival (PFS) will be defined as the time from inclusion to progression or death due to any cause. Overall Survival (OS) will be defined as the time from inclusion to death due to any ca

Source: https://euclinicaltrials.eu/ctis-public/view/2024-515552-21-00